EU clinical trial 2023-510378-14-00: Effect of nucleoside reverse transcriptase inhibitors on innate immune priming
Protocol code: PHARM-202202
Sponsor: Rheinische Friedrich-Wilhelms-Universitaet Bonn (Educational Institution). Phase: Human Pharmacology (Phase I)- Other. Countries: Germany (ongoing, recruitment ended).
Therapeutic area(s): Phenomena and Processes [G] - Microbiological Phenomena [G06]; Diseases [C] - Virus Diseases [C02]; Phenomena and Processes [G] - Immune system processes [G12]; Phenomena and Processes [G] - Immune System Phenomena [G13]
Gender: Male. Age: 18-64 years. Enrolment: 12.
Status: Ongoing, recruitment ended. Start date (EU): 2024-06-20. Decision date: 2024-05-08. Results received: No. Last updated: 2024-05-08.

Condition(s): modulation of the innate immune system in healthy subjects

Source: https://euclinicaltrials.eu/ctis-public/view/2023-510378-14-00